EU clinical trial 2024-518251-31-00: Comparison of Landiolol versus standard of care for prevention of mortality in patients hospitalized for a septic shock with hypercontractlity: an open label prospective randomized study
Protocol code: PI2020_843_0057
Sponsor: Centre Hospitalier Universitaire Amiens Picardie (Hospital/Clinic/Other health care facility). Phase: Therapeutic confirmatory (Phase III). Countries: France (ongoing, recruiting).
Therapeutic area(s): Diseases [C] - Cardiovascular Diseases [C14]; Diseases [C] - Bacterial Infections and Mycoses [C01]
Gender: Female, Male. Age: 18-64 years, 65+ years. Enrolment: 360.
Status: Ongoing, recruiting. Start date (EU): 2024-10-22. Decision date: 2024-10-22. Results received: No. Last updated: 2025-07-09.

Condition(s): patients hospitalized for a septic shock with hypercontractlity
Product: CHLORURE DE SODIUM 0,9 % AGUETTANT, solution pour perfusion, Rapibloc 300 mg powder for solution for infusion.

Primary endpoint: mortality at day 28
Endpoint(s): - Number of patients that achieved a reduction of heart rate equal or higher to 20% of the initial HR with landiolol, - Number of days receiving catecholamines, - Number of days receiving mechanical ventilation, - Length of stay in ICU and hospital, - SOFA score at inclusion and day 1, 2, 3, 7, 14 and 28 following the inclusion, - Number of patients developing atrial fibrillation of flutter during the first three days, - Hospital mortality, - Number of episodes of bradycardia (<50 bpm) or LVEF < 45% or MAP <65mmHg requiring an increase of Norepinephrine > 40% during the entire period of treatment with the landiolol, - Unexpected cardiac arrest

Source: https://euclinicaltrials.eu/ctis-public/view/2024-518251-31-00